EU clinical trial 2022-502285-24-00: Open-label clinical phase 1/2 study to assess the safety and efficacy of the SpectraCure P18 System (Interstitial multiple diode lasers and IDOSE® Software) and verteporfin for injection (VFI) for the treatment of recurrent prostate cancer
Protocol code: SPC11-01-110
Sponsor: SpectraCure AB (publ) (Pharmaceutical company). Phase: Phase I and Phase II (Integrated)- First administration to humans. Countries: Germany (not authorised), Sweden (ongoing, recruiting).
Therapeutic area(s): Diseases [C] - Neoplasms [C04]
Gender: Male. Age: 18-64 years, 65+ years. Enrolment: 26.
Start date (EU): 2024-03-01. Decision date: 2023-02-21. Results received: No. Last updated: 2026-02-04.
Decision dates by country: DE: 2023-02-22, SE: 2023-02-24

Condition(s): Recurrent prostate cancer
Product: CIPROFLOXACIN, Visudyne 15 mg powder for solution for infusion

Primary endpoint: Phase 1: Safety will be evaluated by toxicity related to protocol therapy, scored according to CTCAE v4.0. In addition, PDT-mediated severe damage to the periprostatic tissues, including the rectal wall, will be evaluated by contrast-enhanced and non-contrast MRI images obtained 5-9 days following PDT., Phase 1: Performance endpoint for the SpectraCure P18 System (Interstitial multiple diode lasers and IDOSE® Software) will be evaluated by light dose-volume histograms for the light dose coverage. Light dose coverage >90% of the target volume evaluated by dose-volume histograms in >80% of subjects., Phase 2: Efficacy - Percentage of subjects with negative biopsies (histopathologically tumor-free) 6 months after PDT procedure. A proportion of subjects with negative biopsies of 0.75 at 6 months in phase 2 is expected and is considered clinically meaningful.
Endpoint(s): Phase 1: Adequacy of effectiveness will be evaluated by MRI within one week to determine the extent of necrosis in the prostate (>70% of target volume in >50% of subjects)., Phase 2: Efficacy - Percentage of subjects with remaining localized tumour evaluated by MRI 12 months following PDT. Percentage of subjects with biochemical failure defined as a rise in PSA level of 2.0 ng/mL or more, over and above the nadir obtained 6 weeks following PDT, confirmed by a second PSA value 4 weeks later. Percentage of subjects with extra prostatic or distant disease evaluated by PSMA PET 12 months following PDT in case of biochemical failure., Phase 2: Performance - The SpectraCure P18 System (Interstitial multiple diode lasers and IDOSE® Software) will be evaluated by light dose-volume histograms for the light dose coverage. Light dose coverage >90% of the target volume evaluated by dose-volume histograms in >80% of subjects., Phase 2: Safety - Adverse events will be collected throughout the study. Assessment of toxicity according to CTCAE v5.0 related to therapy per protocol. In addition, any PDT-mediated severe damage to the periprostatic tissues will be evaluated by MRI images obtained 5-9 days post-PDT. The threshold for success is anticipated to be no Grade 3 toxicity to the rectum or bladder assessed on MRI or any drug-related Serious Adverse Events.

Source: https://euclinicaltrials.eu/ctis-public/view/2022-502285-24-00